EU clinical trial 2025-522498-12-00: A low-intervention randomised, double-blind, placebo-controlled pilot trial evaluating the feasibility, tolerability and adherence of alternate-day oral Duroferon (ferrous sulphate) in adolescent girls with iron deficiency, and the diagnostic performance of the IRON-5 screening tool (IRONGIRLS-PILOT).
Sponsor: Region Skane (Hospital/Clinic/Other health care facility). Phase: Therapeutic use (Phase IV). Countries: Sweden (authorised, recruitment pending).
Therapeutic area(s): Not possible to specify; Health Care [N] - Environment and Public Health [N06]
Gender: Female. Age: 0-17 years, 18-64 years. Enrolment: 279.
Status: Authorised, recruitment pending. Decision date: 2026-04-14. Results received: No. Last updated: 2026-04-14.

Condition(s): iron deficiency in adolescent girls
Product: Duroferon depottabletter, Duroferon placebo

Primary endpoint: 1. Feasibility, including recruitment, retention, adherence and tolerability. 2. Diagnostic performance of IRON-5 (sensitivity, specificity, positive and negative predictive values, and ROC-AUC).
Endpoint(s): Change in ferritin concentration., Change in haemoglobin, TSAT, vitamin B12 and 25-hydroxyvitamin D from screening to follow-up., Associations between iron deficiency and selected factors (dietary patterns, BMI, menstrual characteristics including bleeding volume, menstrual pain and analgesic use, hormonal contraceptive use, physical activity, socioeconomic status and country of birth)., Associations between fatigue and self-rated QoL and factors other than iron deficiency (e.g. vitamin B12 and vitamin D deficiency, anxiety/depression and lifestyle factors).

Source: https://euclinicaltrials.eu/ctis-public/view/2025-522498-12-00